EU clinical trial 2023-504384-16-00: Prospective study to evaluate the efficacy of letermovir prophylaxis for the prevention of CMV infection in lung transplant recipients compared to a retrospective cohort treated with standard valganciclovir prophylaxis for 12 months (LETERCOR Study)
Protocol code: FCO-LET-2022-01
Sponsor: Fundacion Para La Investigacion Biomedica De Cordoba (Laboratory/Research/Testing facility). Phase: Therapeutic exploratory (Phase II). Countries: Spain (ongoing, recruitment ended).
Therapeutic area(s): Diseases [C] - Virus Diseases [C02]
Gender: Female, Male. Age: 18-64 years, 65+ years. Enrolment: 70.
Status: Ongoing, recruitment ended. Start date (EU): 2023-12-18. Decision date: 2023-08-24. Results received: No. Last updated: 2025-12-17.

Condition(s): lung transplant patients (D+/R-)
Product: PREVYMIS 240 mg film-coated tablets

Primary endpoint: Incidence of CMV disease/replication for 12 months after initiation of prophylaxis.
Endpoint(s): Administered doses of Letermovir or Valganciclovir, CMV Medications: Any non-antiviral therapy received as SoC for CMV management (eg immunoglobulins), Changes in the patient's medication directly related to the toxicity of CMV antivirals, Incidence of leukopenia. (Leukopenia will be considered if the total leukocyte number is less than 3,000/mL and neutropenia if the total neutrophil number is less than 1,000/mL), Hospital readmission associated with CMV complications, Incidence of opportunistic viral, bacterial, or fungal infections during the study follow-up period, Incidence of renal toxicity directly related to CMV antivirals, Rate of patients achieving functional CMV-specific cell-mediated immunity (CMI-CMV) levels after receiving letermovir prophylaxis during the 6 months following discontinuation., Rate of CMV-seropositive patients after receiving letermovir prophylaxis during the 6 months following discontinuation

Source: https://euclinicaltrials.eu/ctis-public/view/2023-504384-16-00